EU clinical trial 2025-521884-12-00: A Phase III, multisite, randomized, double-blind trial of BNT327 in combination with chemotherapy versus placebo with chemotherapy in patients with previously untreated locally recurrent inoperable or metastatic TNBC determined ineligible for PD(L)1 therapy based on PD-L1 negative disease
Protocol code: BNT327-05
Sponsor: BioNTech SE (Pharmaceutical company). Phase: Therapeutic confirmatory (Phase III). Countries: Czechia (authorised, recruitment pending), Poland (ongoing, recruiting), Italy (ongoing, recruiting), France (not authorised), Belgium (ongoing, recruiting), Netherlands (authorised, recruitment pending), Germany (authorised, recruiting), Spain (ongoing, recruiting).
Therapeutic area(s): Diseases [C] - Neoplasms [C04]
Gender: Female, Male. Age: 18-64 years, 65+ years. Enrolment: 169.
Start date (EU): 2026-03-19. Decision date: 2026-03-04. Results received: No. Last updated: 2026-07-20.
Decision dates by country: FR: 2026-03-09, PL: 2026-03-07, CZ: 2026-03-04, ES: 2026-03-05, NL: 2026-03-09, BE: 2026-03-04, DE: 2026-03-04, IT: 2026-03-04

Condition(s): First line triple-negative breast cancer (TNBC)
Product: BNT327 1-15, PACLITAXEL, ERIBULIN, BNT327 Placebo, CARBOPLATIN, GEMCITABINE, Abraxane 5 mg/ml powder for dispersion for infusion.

Primary endpoint: Overall survival (OS) defined as the time from randomization to death from any cause., Progression-free survival (PFS) defined as the time from randomization to first documented tumor progression (assessed by blinded independent central review (BICR) per RECIST v1.1), or death from any cause, whichever occurs first.
Endpoint(s): Objective response rate (ORR) defined as the proportion of patients in whom a confirmed complete response (CR) or confirmed partial response (PR) (per RECIST v1.1) is assessed by BICR as best overall response., PFS defined as the time from randomization to first documented tumor progression (assessed by investigator per RECIST v1.1), or death from any cause, whichever occurs first., Objective response rate (ORR) defined as the proportion of patients in whom a confirmed complete response (CR) or confirmed partial response (PR) (per RECIST v1.1) is observed as best overall response., Duration of response (DOR) defined as the time from first objective response (CR or PR per RECIST v1.1) to first occurrence of objective tumor progression (progressive disease per RECIST v1.1), or death from any cause, whichever occurs first, Disease control rate (DCR) defined as the proportion of patients in whom a confirmed CR or confirmed PR or SD (per RECIST v1.1, SD assessed at least 6 weeks after randomization) is observed as best overall response., Progression-free survival (PFS) rate as assessed by BICR at 6, 12, 18, and 24 months., Progression-free survival (PFS) rate as assessed by investigator at 6, 12, 18, and 24 months., Overall survival (OS) rate at 6, 12, 18, and 24 months., Occurrence of treatment-emergent adverse events (TEAEs) including Grade ≥3 according to NCI CTCAE v5.0, serious, and fatal TEAEs by relationship, from the first dose of pumitamig or placebo to 90 days after last dose of trial treatment., Occurrence of dose interruption, reduction, and discontinuation of trial treatment due to TEAEs (including related TEAEs) from the first dose of pumitamig or placebo to 90 days after last dose of trial treatment., Change from baseline in EORTC Quality of Life (QLQ)-C30 Global Health status / Quality-of-Life score (Items 29 and 30)., Change from baseline in EORTC QLQ-C30 physical functioning., Change from baseline in arm symptoms scale of the EORTC QLQ-BR42., Change from baseline in breast symptoms scale of the EORTC QLQ-BR42., Change from baseline in the Functional Assessment of Cancer Therapy - General (FACT-G) overall bother item (FACT-GP5).

Source: https://euclinicaltrials.eu/ctis-public/view/2025-521884-12-00